EU clinical trial 2024-518925-14-02: Virus-specific T-cell Immunity for the Treatment of Some Resistant Viral Infections After Allogeneic Hematopoietic Stem Cell Transplantation (HSCT)
Protocol code: PTC:VS-TC
Sponsor: IRCCS Istituto Giannina Gaslini (Hospital/Clinic/Other health care facility). Phase: Human Pharmacology (Phase I)- Other. Countries: Italy (ongoing, recruiting).
Therapeutic area(s): Diseases [C] - Immune System Diseases [C20]
Gender: Female, Male. Age: 0-17 years, 18-64 years. Enrolment: 10.
Status: Ongoing, recruiting. Start date (EU): 2024-07-17. Decision date: 2025-01-31. Results received: No. Last updated: 2025-01-31.

Condition(s): Patients who have received an allogeneic haematopoietic stem cell transplant and who have developed post-transplant viral reactivation (CMV, Adenovirus, EBV) resistant to pharmacological therapies.

Primary endpoint: Adverse events: To collect any adverse event defined as any significant alteration of vital signs and / or organ function, expressed in clinical, hematochemical and radiological findings according to version 5 of the Common Terminology Criteria for Adverse Events (CTCAE)
Endpoint(s): Organ damage; overall survival; specific cell viral immunity; variation of viremia.

Source: https://euclinicaltrials.eu/ctis-public/view/2024-518925-14-02